EU clinical trial 2025-523052-32-00: A Trial to Evaluate the Pharmacodynamics, Pharmacokinetics, Safety, and Tolerability of Insulin GZR33 Compared with Insulin Degludec at steady state in participants with Type 1 Diabetes
Protocol code: GZR33-T1D-US101
Sponsor: Gan & Lee Pharmaceuticals USA Corp. (Pharmaceutical company). Phase: Human Pharmacology (Phase I)- Other. Countries: Germany (ended).
Therapeutic area(s): Diseases [C] - Hormonal diseases [C19]
Gender: Female, Male. Age: 18-64 years. Enrolment: 14.
Status: Ended. Start date (EU): 2025-10-17. End date (EU): 2026-02-18. Decision date: 2025-10-15. Results received: No. Last updated: 2025-10-15.

Condition(s): Type 1 diabetes Mellitus

Source: https://euclinicaltrials.eu/ctis-public/view/2025-523052-32-00